EU clinical trial 2024-516880-10-00: Evaluation de l’efficacité des alpha-bloquants (Tamsulosine) dans le traitement de la dysurie symptomatique de la sclérose en plaques chez la femme – Etude contrôlée randomisée en cross-over contre placebo.
Protocol code: NIMAO/2021-1/EB-01
Sponsor: Centre Hospitalier Universitaire De Nimes (Hospital/Clinic/Other health care facility). Phase: Therapeutic exploratory (Phase II). Countries: France (ended).
Therapeutic area(s): Diseases [C] - Nervous System Diseases [C10]; Diseases [C] - Female Urogenital Diseases and Pregnancy Complications [C13]
Gender: Female. Age: 18-64 years, 65+ years. Enrolment: 30.
Status: Ended. Start date (EU): 2022-06-08. End date (EU): 2025-06-27. Decision date: 2024-09-05. Results received: No. Last updated: 2024-09-05.

Condition(s): Patiente atteinte de sclérose en plaques (score EDSS < 7,5) avec dysurie modérée à sévère (score IPSS > 7) par dyssynergie vésico-sphinctérienne authentifiée au bilan urodynamique complet.
Product: microcrystalline cellulose, Tamsulosin Gemax Pharma 0,4 mg capsule cu eliberare prelungită

Primary endpoint: Evolution du score au questionnaire IPSS (International Prostate Symptom Scale) entre le début de la séquence de traitement (période A ou B) (J0) et la fin de la séquence de traitement, soit à un mois.
Endpoint(s): Evolution du score au questionnaire USP (Urinary Symptom Profile) entre le début de la séquence de traitement (période A ou B) (J0) et la fin de la séquence de traitement, soit à un mois., Evolution du résidu post mictionnel (en ml) par BladderScan entre le début de la séquence de traitement (période A ou B) (J0) et la fin de la séquence de traitement, soit à un mois., Evolution du Qmax (débit urinaire maximal en ml/s) par la réalisation d'une débitmétrie libre entre le début (J0) et la fin de la séquence de traitement, soit à un mois., Evolution des questionnaires Qualiveen®, EQ-5D et MFIS entre le début (J0) et la fin de la séquence de traitement, soit à un mois., Survenue (oui/non) des évènements indésirables suivants : céphalées, asthénie, troubles gastro-intestinaux, hypotension orthostatique.

Source: https://euclinicaltrials.eu/ctis-public/view/2024-516880-10-00